EU clinical trial 2022-502110-85-00: A Phase 3, Double-blind, Placebo-controlled, Randomized Study to Assess the Efficacy and Safety of Epicutaneous Immunotherapy with DBV712 250 μg in 4-7-year-old Children with Peanut Allergy (VITESSE)
Protocol code: V712-306
Sponsor: Dbv Technologies (Pharmaceutical company). Phase: Therapeutic confirmatory (Phase III). Countries: Netherlands (ongoing, recruitment ended), Ireland (ongoing, recruitment ended), Germany (ongoing, recruitment ended), Spain (ongoing, recruitment ended), France (ongoing, recruitment ended).
Therapeutic area(s): Diseases [C] - Immune System Diseases [C20]
Gender: Female, Male. Age: 0-17 years. Enrolment: 126.
Status: Ongoing, recruitment ended. Start date (EU): 2024-01-18. Decision date: 2023-07-11. Results received: No. Last updated: 2026-07-15.
Decision dates by country: FR: 2023-07-17, DE: 2023-07-12, NL: 2023-07-14, IE: 2023-07-17, ES: 2023-07-11

Condition(s): Peanut allergy
Product: 0.67% Peanut Challenge Meal (PCM) base, granules for oral suspension, Soluprick Positive control, 10 mg/ml, Solution for skin-prick test, 20% Peanut Challenge Meal (PCM) base, granules for oral suspension, The DBV712 placebo cutaneous system is exactly the same as the DBV712 250 mcg system, but with a deposit free of peanut proteins., Soluprick Negative control, Solution for skin prick test, Viaskin Peanut, 0% Peanut Challenge Meal (PCM) base, granules for oral suspension, ALK 762 Jordnød Opløsning til priktest (Soluprick); Nøddeallergen

Primary endpoint: Primary endpoints: Percentage of treatment responders in the DBV712 250 μg group compared to the placebo group after 12 months of treatment in the target population. A subject is defined as a treatment responder if: - The initial ED was ≤ 30 mg peanut protein and the ED is ≥ 300 mg peanut protein at the post-treatment DBPCFC at Month 12; OR, - The initial ED was > 30 mg peanut protein and the ED is ≥ 600 mg peanut protein at the post-treatment DBPCFC at Month 12, Safety: The following safety criteria will be evaluated: - Adverse events and treatment-emergent AEs (TEAEs) - Assessment of pain and ease of removal of DBV712 - AESIs defined as: o Local AESIs: severe local site reactions (grade 4 with loss of skin barrier integrity), o Systemic AESIs: systemic allergic reactions, including those leading to epinephrine use, whatever the causal relationship to DBV712 250 μg o AEs leading to epinephrine use, irrespective of the causal relationship to DBV712 250 μg o AEs leading to inhaled or systemic corticosteroid use, irrespective of the causal relationship to DBV712 250 μg, - Systemic allergic reactions (Graded by CoFAR Grading Scale for Systemic Allergic Reactions V3.0 [APPENDIX 2]) - AE leading to topical corticosteroids use - Serious adverse events (SAEs) - Physical examinations (including grading any inflammation at system sites), SCORAD and vital signs
Endpoint(s): CRD of peanut protein after 12 months of treatment in the DBV712 250 μg group versus the placebo group. CRD will also be presented in each of the 2 screening ED subgroups;, ED of peanut protein after 12 months of treatment in the DBV712 250 μg group versus the placebo group. ED will also be presented in each of the 2 screening ED subgroups;, Percentage of subjects with an ED ≥ 600 mg and the percentage of subjects with an ED ≥ 1000 mg peanut protein at Month 12 in the DBV712 250 μg group versus the placebo group, overall, and in each of the 2 screening ED subgroups;, Maximum severity of allergic reaction at baseline and Month 12 Food Challenge in the DBV712 250 μg group versus the placebo group.

Source: https://euclinicaltrials.eu/ctis-public/view/2022-502110-85-00